EU clinical trial 2023-508169-34-00: Efficacy and safety of Escholzia tablets in adults with insomnia: a biphasic study with a randomized, placebo-controlled, double-blind, 1-month interventional, clinical trial phase (A) and a subsequent prospective, 1-armed, 2-months interventional trial phase (B).
Protocol code: Vo02-2023
Sponsor: A.Vogel AG (Pharmaceutical company). Phase: Therapeutic confirmatory (Phase III). Countries: Germany (not authorised).
Therapeutic area(s): Not possible to specify
Gender: Female, Male. Age: 18-64 years. Enrolment: 100.
Status: Not authorised. Decision date: 2023-11-28. Results received: No. Last updated: 2023-11-28.

Condition(s): Insomnia (ICD-10 F51.0)
Product: Placebo tablet that matches the verum in its sensorical properties and posology, but without any active pharmaceutical ingredient., AV-EC2023

Primary endpoint: Phase (A): Change in perceived sleep quality as measured with the Insomnia Severity Index (ISI), Phase (B): Safety and tolerability of treatment according to safety assessment
Endpoint(s): Change in perceived sleep quantity/quality as per the daily sleep diary, Change in physiological sleep quantity as measured via actigraphy (wearable), Change in daytime sleepiness as measured with the Epworth-Sleepiness-Scale (ESS), Change in state anxiety as measured with the State-Trait-Anxiety-Inventory (STAI-X1), Change in mood as measured with the Depression, Anxiety, Stress Scale (DASS-21), Change in general quality of life as measured with the World Health Organization Quality of Life inventory (WHOQOL)-BREF, Change in happiness and satisfaction via the Oxford Happiness Questionnaire (OHQ), Domain specific cognitive performance as measured via the Computerized Mental Performance Assessment System (COMPASS), Change in biomarker for stress via the salivary evening cortisol level (8 pm), Change in biomarker for sleep readiness via the salivary evening melatonin level (8 pm), Change in biomarker for chronic stress via the CAR determined as area under the curve (AUC) and increase, Change in pain intensities, Change in sleep quantity as measured via PSG device

Source: https://euclinicaltrials.eu/ctis-public/view/2023-508169-34-00